EU clinical trial 2024-512177-27-01: A phase 3, randomised, multi-center, open label trial to evaluate the safety and efficacy of intravesical nadofaragene firadenovec alone or in combination with chemotherapy (gemcitabine and docetaxel) or immunotherapy (pembrolizumab) in subjects with high-grade Bacillus Calmette-Guerin therapy (BCG) unresponsive non-muscle invasive bladder cancer (NMIBC)
Protocol code: 000434
Sponsor: Ferring Pharmaceuticals A/S (Pharmaceutical company). Phase: Therapeutic confirmatory (Phase III). Countries: Spain (ongoing, recruiting), Denmark (authorised, recruitment pending), Poland (ongoing, recruiting), Czechia (ongoing, recruiting), France (ongoing, recruiting).
Therapeutic area(s): Diseases [C] - Female Urogenital Diseases and Pregnancy Complications [C13]; Diseases [C] - Male Urogenital Diseases [C12]
Gender: Female, Male. Age: 18-64 years, 65+ years. Enrolment: 141.
Start date (EU): 2025-09-29. Decision date: 2025-09-01. Results received: No. Last updated: 2026-06-29.
Decision dates by country: PL: 2025-09-08, CZ: 2025-09-03, DK: 2025-09-01, FR: 2025-09-01, ES: 2025-09-03

Condition(s): High-risk Bacillus Calmette-Guerin (BCG)-unresponsive non-muscle-invasive bladder cancer (NMIBC) with carcinoma in situ(CIS) with or without papillary tumours
Product: GEMCITABINE, ADSTILADRIN, KEYTRUDA 25 mg/mL concentrate for solution for infusion, DOCETAXEL

Primary endpoint: Complete response ([CR] at any time from first treatment defined as absence of high-grade (HG) recurrence)

Source: https://euclinicaltrials.eu/ctis-public/view/2024-512177-27-01